EU clinical trial 2024-516494-73-00: FORMAT Study : Use of fibrinogen in the treatment of bleeding in thrombopenic patients after intensive chemotherapy refractory to platelet transfusion - evaluation by rotem viscoelastometry (pilot single-center study).
Protocol code: 2021-0201
Sponsor: Centre Hospitalier Universitaire De Saint Etienne (Hospital/Clinic/Other health care facility). Phase: Therapeutic exploratory (Phase II). Countries: France (ended).
Therapeutic area(s): Diseases [C] - Hemic and Lymphatic Diseases [C15]
Gender: Female, Male. Age: 18-64 years, 65+ years. Enrolment: 10.
Status: Ended. Start date (EU): 2022-02-10. End date (EU): 2025-12-17. Decision date: 2024-08-29. Results received: No. Last updated: 2024-10-24.

Condition(s): Hematological malignancy
Product: CLOTTAFACT 1,5 G/100 ML, POUDRE ET SOLVANT POUR SOLUTION INJECTABLE

Primary endpoint: Effect of the administration of fibrinogen and the transfusion of a platelet concentrate on the visco-elastometric parameter 'maximum clot elasticity' (MCE) deduced from the MCF "maximum clot firmness" of the EXTEM curve (ROTEM - initiation of coagulation with tissue factor) between the 1st and 3rd laboratory investigation (1st before administration of fibrinogen, and 3rd after administration of fibrinogen and platelets).
Endpoint(s): Comparison of the ROTEM viscoelastometric parameters before and after treatment, under EXTEM and FIBTEM conditions (determination of the contribution of fibrinogen) and with all the other ROTEM parameters between the 1st, 2nd and 3rd laboratory investigation., Comparison of all parameters in ROTEM viscoelastometry under EXTEM and FIBTEM conditions before and after platelet transfusion as a function of CCI and the cause in the refractory state., Comparison of parameters in ROTEM viscoelastometry before and after platelet transfusion as a function of the characteristics of the platelet concentrates., Comparison of the ROTEM viscoelastometry parameters before and after fibrinogen as a function of the dose received relative to the patient's weight and the plasma concentration of fibrinogen, Incidence of hemorrhagic events and thrombotic events, Collection of hemorrhagic and thrombotic risk factors., Time from diagnosis of bleeding to administration of treatment; delay between the first ROTEM results and the administration of treatments; and ROTEM results before and after procedures., Time to get the first ROTEM result and the result of conventional coagulation tests and complete blood count after blood collection., Collection of adverse events and serious adverse events.

Source: https://euclinicaltrials.eu/ctis-public/view/2024-516494-73-00